EU clinical trial 2023-506528-95-00: A MULTICENTER, OPEN-LABEL EXTENSION STUDY TO ASSESS THE LONG-TERM SAFETY, TOLERABILITY, AND EFFICACY OF BIMEKIZUMAB IN THE TREATMENT OF SUBJECTS WITH ACTIVE PSORIATIC ARTHRITIS
Protocol code: PA0012
Sponsor: UCB Biopharma (Pharmaceutical company). Phase: Therapeutic confirmatory (Phase III). Countries: Italy (ended), Germany (ended), Czechia (ended), France (ended), Hungary (ended), Poland (ended), Belgium (ended), Spain (ended).
Therapeutic area(s): Diseases [C] - Immune System Diseases [C20]
Gender: Female, Male. Age: 18-64 years, 65+ years. Enrolment: 741.
Status: Ended. Start date (EU): 2019-11-21. End date (EU): 2026-05-21. End date: 2026-05-26. Decision date: 2024-07-11. Results received: No. Last updated: 2026-01-28.
Decision dates by country: DE: 2024-07-12, IT: 2024-07-24, ES: 2024-07-12, PL: 2024-07-15, BE: 2024-07-12, FR: 2024-07-11, HU: 2024-07-15, CZ: 2024-07-11

Condition(s): Psoriatic Arthritis
Product: bimekizumab

Primary endpoint: 1. Incidence of treatment-emergent adverse events (TEAEs) during the study 2. Incidence of treatment-emergent serious adverse events (SAEs) during the study
Endpoint(s): TEAEs leading to withdrawal from investigational medicinal product (IMP) during the study, American College of Rheumatology 20% improvement (ACR20) response at Week 24 in PA0012 using the Baseline of PA0010 or PA0011, American College of Rheumatology 20% improvement (ACR20) response at Week 52 in PA0012 using the Baseline of PA0010 or PA0011, American College of Rheumatology 20% improvement (ACR20) response at Week 140 in PA0012 using the Baseline of PA0010 or PA0011, American College of Rheumatology 50% improvement (ACR50) response at Week 24 in PA0012 using the Baseline of PA0010 or PA0011, American College of Rheumatology 50% improvement (ACR50) response at Week 52 in PA0012 using the Baseline of PA0010 or PA0011, American College of Rheumatology 50% improvement (ACR50) response at Week 140 in PA0012 using the Baseline of PA0010 or PA0011, American College of Rheumatology 70% improvement (ACR70) response at Week 24 in PA0012 using the Baseline of PA0010 or PA0011, American College of Rheumatology 70% improvement (ACR70) response at Week 52 in PA0012 using the Baseline of PA0010 or PA0011, American College of Rheumatology 70% improvement (ACR70) response at Week 140 in PA0012 using the Baseline of PA0010 or PA0011, Psoriasis Area Severity Index 75 (PASI75) response at Week 24 in PA0012 using the Baseline of PA0010 or PA0011, Psoriasis Area Severity Index 75 (PASI75) response at Week 52 in PA0012 using the Baseline of PA0010 or PA0011, Psoriasis Area Severity Index 75 (PASI75) response at Week 140 in PA0012 using the Baseline of PA0010 or PA0011, Psoriasis Area Severity Index 90 (PASI90) response at Week 24 in PA0012 using the Baseline of PA0010 or PA0011, Psoriasis Area Severity Index 90 (PASI90) response at Week 52 in PA0012 using the Baseline of PA0010 or PA0011, Psoriasis Area Severity Index 90 (PASI90) response at Week 140 in PA0012 using the Baseline of PA0010 or PA0011, Investigator Global Assessment (IGA) score of 0 (clear) or 1 (almost clear) AND at least a 2-grade reduction at Week 24 from the Baseline of PA0010 or PA0011, Investigator Global Assessment (IGA) score of 0 (clear) or 1 (almost clear) AND at least a 2-grade reduction at Week 52 from the Baseline of PA0010 or PA0011, Investigator Global Assessment (IGA) score of 0 (clear) or 1 (almost clear) AND at least a 2-grade reduction at Week 140 from the Baseline of PA0010 or PA0011, Enthesitis-free state based on the Leeds Enthesitis Index (LEI) at Week 24 in PA0012 using the subgroup of subjects with enthesitis at the Baseline of PA0010 or PA0011, Enthesitis-free state based on the Leeds Enthesitis Index (LEI) at Week 52 in PA0012 using the subgroup of subjects with enthesitis at the Baseline of PA0010 or PA0011, Enthesitis-free state based on the Leeds Enthesitis Index (LEI) at Week 140 in PA0012 using the subgroup of subjects with enthesitis at the Baseline of PA0010 or PA0011, Enthesitis-free state based on the Spondyloarthritis Research Consortium of Canada (SPARCC) index at Week 24 in PA0012 using the subgroup of subjects with enthesitis at the Baseline of PA0010 or PA0011, Enthesitis-free state based on the Spondyloarthritis Research Consortium of Canada (SPARCC) index at Week 52 in PA0012 using the subgroup of subjects with enthesitis at the Baseline of PA0010 or PA0011, Enthesitis-free state based on the Spondyloarthritis Research Consortium of Canada (SPARCC) index at Week 140 in PA0012 using the subgroup of subjects with enthesitis at the Baseline of PA0010 or PA0011, Dactylitis-free state based on the Leeds Dactylitis Index (LDI) at Week 24 in PA0012 using the subgroup of subjects with dactylitis at the Baseline of PA0010 or PA0011, Dactylitis-free state based on the Leeds Dactylitis Index (LDI) at Week 52 in PA0012 using the subgroup of subjects with dactylitis at the Baseline of PA0010 or PA0011, Dactylitis-free state based on the Leeds Dactylitis Index (LDI) at Week 140 in PA0012 using the subgroup of subjects with dactylitis at the Baseline of PA0010 or PA0011

Source: https://euclinicaltrials.eu/ctis-public/view/2023-506528-95-00